EU clinical trial 2023-509156-34-02: VALIDGFR; method VALIDation and evaluation of non-radioactive methods to measure Glomerular Filtration Rate
Sponsor: Universitair Medisch Centrum Groningen (Hospital/Clinic/Other health care facility). Phase: Therapeutic use (Phase IV). Countries: Netherlands (ongoing, recruiting).
Therapeutic area(s): Analytical, Diagnostic and Therapeutic Techniques and Equipment [E] - Diagnosis [E01]
Gender: Female, Male. Age: 18-64 years, 65+ years. Enrolment: 200.
Status: Ongoing, recruiting. Start date (EU): 2026-02-17. Decision date: 2024-06-05. Results received: No. Last updated: 2025-12-31.

Condition(s): Chronic Kidney Disease Kidney Failure
Product: AMINOHIPPURIC ACID, IOTALAMATE MEGLUMINE, Adrenaline CF 1 mg/ml, oplossing voor injectie, OMNIPAQUE 300 mg I/ml, Tavegyl 1 mg/ml, oplossing voor injectie, SODIUM IOTALAMATE (125I)

Primary endpoint: mGFR determined using 125I-Iothalamate and 131I-hippuran, mGFR determined using iohexol

Source: https://euclinicaltrials.eu/ctis-public/view/2023-509156-34-02